EU clinical trial 2026-525317-31-00: Pilot study comparing the efficacy of intra-articular glenohumeral injection combined with suprascapular nerve block versus intra-articular glenohumeral corticosteroid injection in adhesive capsulitis.
Protocol code: RC25_0554
Sponsor: Centre Hospitalier Universitaire De Nantes (Hospital/Clinic/Other health care facility). Phase: Therapeutic exploratory (Phase II). Countries: France (authorised, recruitment pending).
Therapeutic area(s): Diseases [C] - Musculoskeletal Diseases [C05]
Gender: Female, Male. Age: 18-64 years. Enrolment: 38.
Status: Authorised, recruitment pending. Decision date: 2026-05-29. Results received: No. Last updated: 2026-05-29.

Condition(s): Retractile Capsulitis
Product: LIDOCAINE HYDROCHLORIDE, SODIUM CHLORIDE, DIPROSTENE, suspension injectable en seringue pré-remplie

Primary endpoint: The primary endpoint is the difference in Quick DASH scores between enrollment and M3.
Endpoint(s): Assessment of function using a Quick Dash score on D0, M1, M3, M6, and M12 and measurement of the area under the curve., Assessment of pain: VAS on D0, M1, M3, M6, and M12, Measurement of joint range of motion with a goniometer on D0, M1, M3, M6, and M12., EVA pain before and after the procedure; collection of adverse events at Day 0, Month 1, Month 3, Month 6, and Month 12., Time to return to work after the procedure for patients who were employed at Day 0, 1 month, 3 months, 6 months, and 12 months.

Source: https://euclinicaltrials.eu/ctis-public/view/2026-525317-31-00